EU clinical trial 2024-517746-34-00: A phase I study of [68Ga]Ga-DWJ155 in patients with advanced breast and NSCLC cancers
Protocol code: CFKL480A02101
Sponsor: Novartis Pharma AG (Pharmaceutical company). Phase: Human Pharmacology (Phase I)- First administration to humans. Countries: Netherlands (ongoing, recruiting).
Therapeutic area(s): Diseases [C] - Neoplasms [C04]
Gender: Female, Male. Age: 18-64 years, 65+ years. Enrolment: 36.
Status: Ongoing, recruiting. Start date (EU): 2026-06-26. Decision date: 2025-07-03. Results received: No. Last updated: 2026-05-21.

Condition(s): Advanced breast cancer and advanced NSCLC

Source: https://euclinicaltrials.eu/ctis-public/view/2024-517746-34-00